EU clinical trial 2023-506283-13-00: Use of determination of drug levels to optimize pharmacotherapy of heart failure
Sponsor: Fakultni Nemocnice Ostrava (Hospital/Clinic/Other health care facility). Phase: Therapeutic use (Phase IV). Countries: Czechia (ongoing, recruiting).
Therapeutic area(s): Diseases [C] - Cardiovascular Diseases [C14]
Gender: Female, Male. Age: 18-64 years, 65+ years. Enrolment: 100.
Status: Ongoing, recruiting. Start date (EU): 2024-04-09. Decision date: 2023-11-28. Results received: No. Last updated: 2024-03-12.

Condition(s): Chronic heart failure with reduced ejection fraction
Product: NEBIVOLOL, CARVEDILOL, BISOPROLOL FUMARATE, SPIRONOLACTONE, SACUBITRIL VALSARTAN, METOPROLOL SUCCINATE

Primary endpoint: To determine whether in patients with chronic heart failure with reduced ejection fraction (HFrEF) the serum concentration of the drugs used is more important than the dose of these drugs (beta-blockers bisoprolol, carvedilol, metoprolol succinate or nebivolol; spironolactone, sacubitril, valsartan) for compensating the health status)
Endpoint(s): To determine the number of patients in whom a significant dependence between the serum concentration of the mentioned drugs and the values of selected clinical indicators (NT-proBNP concentration, 6-minute walk test, quality of life questionnaire, echocardiographic parameters, hospitalization for HFrEF, length of survival) is demonstrated., To determine the number of patients in whom a significant dependence between the serum concentration of the mentioned drugs and the adverse effects of these drugs is demonstrated, To determine the number of patients in whom non-adherence to treatment will be demonstrated

Source: https://euclinicaltrials.eu/ctis-public/view/2023-506283-13-00